EU clinical trial 2022-500451-23-00: StrateGlio: Phase III randomised trial evaluating early treatment intensification with temozolomide in adults with a glioblastoma
Protocol code: StrateGlio-1802
Sponsor: Centre Oscar Lambret (Pharmaceutical company). Phase: Therapeutic confirmatory (Phase III). Countries: France (ongoing, recruitment ended), Belgium (ongoing, recruitment ended).
Therapeutic area(s): Analytical, Diagnostic and Therapeutic Techniques and Equipment [E] - Therapeutics [E02]
Gender: Female, Male. Age: 18-64 years, 65+ years. Enrolment: 460.
Status: Ongoing, recruitment ended. Start date (EU): 2019-03-18. Decision date: 2024-07-15. Results received: No. Last updated: 2025-11-10.
Decision dates by country: BE: 2025-11-10, FR: 2024-07-15

Condition(s): Adults with a de novo glioblastoma
Product: TEMOZOLOMIDE

Primary endpoint: Overall survival will be defined as time interval from randomization to death whatever the cause. Patients alive will be censored at the date of last news.
Endpoint(s): Adverse events occurring from randomization until disease progression will be reported and graded using the NCI-CTCAE v5.0 classification, including those related to the underlying disease or its progression. All AE will be analyzed, and described according to the reported causal relationship. An AE will be classified as Severe AE if grade is equal or higher than 3 for extra-hematological AE and grade 4 for hematological AE., Progression-free survival will be defined as time interval from randomization to the first occurrence of progression according to RANO criteria as assessed by the treating physician, or death whatever the cause. Patients alive without progressive disease will be censored at the date of last news. There will be no central radiological review. The type of progression will be collected (local or peri-local, remotely in the brain, remotely in the meninges), Q-TWiST: Quality-adjusted time without symptoms of disease or adverse event, Exploratory endpoints: Treatment doses will be computed for each treatment component (radiotherapy & chemotherapy), and by treatment phase (early TMZ / concomitant TMZ / adjuvant TMZ). Early administration of TMZ is unlikely to result in leucopenia and/or thrombocytopenia, which could prevent or inhibit conventional concomitant standard dose chemoradiotherapy. It could also lead to platelet transfusions or infections. Patients will be notified. The percentage of deliveries of complete chemoradio, Total dose of irradiation received and dose-intensity., Predictive factors of overall survival: the list of studied factors will be defined later. The methylation of the MGMT promoter is mandatory and will be done in each center. Tumor material will be stored in order to study other biomarkers., Description of the post-progression treatments: nature and duration.

Source: https://euclinicaltrials.eu/ctis-public/view/2022-500451-23-00